EU clinical trial 2022-503137-66-00: A Phase 3b, multicenter, single-arm, open-label study evaluating the efficacy, safety, and tolerability of switching to DTG/3TC single tablet regimen administered once daily from a bictegravir/emtricitabine/tenofovir alafenamide single tablet regimen in people living with HIV of at least 50 years of age who are virologically suppressed
Protocol code: 219516
Sponsor: Viiv Healthcare UK Limited (Pharmaceutical company). Phase: Therapeutic confirmatory (Phase III). Countries: Belgium (ended), Italy (ended), Portugal (ended), Austria (ended), Spain (ended), Germany (ended), France (ended), Netherlands (ended).
Therapeutic area(s): Diseases [C] - Virus Diseases [C02]
Gender: Female, Male. Age: 18-64 years, 65+ years. Enrolment: 117.
Status: Ended. Start date (EU): 2023-11-29. End date (EU): 2026-01-14. End date: 2026-02-10. Decision date: 2023-11-10. Results received: No. Last updated: 2025-11-23.
Decision dates by country: PT: 2023-11-14, NL: 2023-11-16, IT: 2023-11-14, BE: 2023-11-13, DE: 2023-11-14, ES: 2023-11-10, FR: 2023-11-10, AT: 2023-11-15

Condition(s): Human immunodeficiency virus (HIV)
Product: Dovato 50 mg/300 mg film-coated tablets, Biktarvy 50 mg/200 mg/25 mg film-coated tablets

Primary endpoint: Participants with plasma HIV-1 RNA ≥ 50 copies/mL (Snapshot algorithm) at Week 48
Endpoint(s): Participants with plasma HIV-1 RNA ≥ 50 copies/mL (Snapshot algorithm) at 24 and 96 weeks Participants with plasma HIV-1 RNA <50 copies/mL (Snapshot algorithm) at 24, 48 and 96 weeks Absolute values and changes from baseline in CD4+ cells count and CD4:CD8 ratio at 24, 48 and 96 weeks Occurrence of disease progression (HIV associated conditions, AIDS, and death) through Weeks 24, 48 and 96., Occurrence of viral resistance in participants meeting confirmed virologic withdrawal criterion over time, Occurrence of DTG/3TC-non-Serious Adverse drug-related reactions, all SAEs and proportion of participants who discontinue treatment due to AEs

Source: https://euclinicaltrials.eu/ctis-public/view/2022-503137-66-00